EU clinical trial 2023-509503-33-00: Randomized and controlled clinical trial of the efficacy and safety of the use of lidocaine and magnesium sulfate for lung resection surgery using Video-Assisted Thoracic Surgery (VATS)
Sponsor: Clinica Universidad De Navarra (Hospital/Clinic/Other health care facility). Phase: Therapeutic use (Phase IV). Countries: Spain (authorised, recruiting).
Therapeutic area(s): Diseases [C] - Respiratory Tract Diseases [C08]
Gender: Female, Male. Age: 18-64 years, 65+ years. Enrolment: 128.
Status: Authorised, recruiting. Start date (EU): 2025-11-25. Decision date: 2024-05-07. Results received: No. Last updated: 2025-07-29.

Condition(s): Lung resection surgery using Video-Assisted Thoracic Surgery (VATS)
Product: Suero fisiológico 0,9% Baxter (Clear Flex) solución para perfusión, Lidocaína B. Braun 20 mg/ml solución inyectable, Sulfato de Magnesio Altan 150 mg/ml solución inyectable y para perfusión EFG

Primary endpoint: Morphine consumption in the first 24 postoperative hours.
Endpoint(s): Postoperative morphine consumption, Intensity of pain, at rest and with deep breathing, Chronic postoperative pain, Neuropathic pain, ICU stay and hospital stay., Adverse events, Serious and non-serious pulmonary complications, Non-pulmonary complications, Myocardial damage in non-cardiac surgery, Major Cardiovascular Events, Atrial Fibrillation, Postoperative surgical complications, Quality of life, Postoperative cognitive dysfunction, Acute Kidney Injury, Recovery quality, Severity of postoperative complications, Lung capacity, Oxygenation, Hospital readmissions, Lung cancer recurrences

Source: https://euclinicaltrials.eu/ctis-public/view/2023-509503-33-00